EU clinical trial 2022-501257-36-00: A Phase I/II Study of Pembrolizumab (MK-3475) in children with advanced melanoma or a PD-L1 positive advanced, relapsed or refractory solid tumor or lymphoma (KEYNOTE-051)
Protocol code: MK3475-051
Sponsor: Merck Sharp & Dohme LLC (Pharmaceutical company). Phase: Phase I and Phase II (Integrated)- Other. Countries: Italy (ongoing, recruiting), Germany (ongoing, recruiting), Sweden (ongoing, recruiting), France (ongoing, recruiting), Netherlands (ended), Portugal (ended).
Therapeutic area(s): Diseases [C] - Neoplasms [C04]
Gender: Female, Male. Age: 0-17 years. Enrolment: 69.
Start date (EU): 2015-03-19. Decision date: 2023-04-03. Results received: No. Last updated: 2026-07-28.
Decision dates by country: DE: 2023-04-05, SE: 2023-04-03, NL: 2023-07-17, PT: 2024-03-11, FR: 2023-04-04, IT: 2023-04-05

Condition(s): Treatment of adjuvant melanoma, advanced melanoma, or advanced, relapsed or refractory PD-L1 positive malignant solid tumor or other lymphoma, relapsed or refractory classical Hodgkin lymphoma (rrcHL), advanced, relapsed or refractory microsatellite-instability-high (MSI-H) solid tumors, or any advanced relapsed or refractory solid tumor that is tumormutational-burden ≥10 mut/Mb (TMB-H), excluding MSIH/deficient mismatch repair (dMMR) tumors, as measured by the F1CDx™ assay in children from 6 months (or 3 years for rrcHL Cohort) to less than 18 years old.
Product: KEYTRUDA 25 mg/mL concentrate for solution for infusion

Primary endpoint: Objective Response Rate (ORR) by Response Evaluation Criteria in Solid Tumors and Other Lymphoma Version 1.1 (RECIST 1.1) per Site Assessment (Each Disease Indication Evaluated Separately), ORR by RECIST 1.1 per Site Assessment for Microsatellite Instability-High (MSI-H) or Tumor Mutational Burden-High (TMB-H) Solid Tumors (Each Cohort Evaluated Separately), ORR by International Working Group (IWG) Response Criteria (Cheson, 2007) per Blinded Independent Central Review (BICR) Assessment for Relapsed Refractory Classical Hodgkin lymphoma (rrcHL) Cohort, Number of Participants with Dose-Limiting Toxicities (DLTs), Number of Participants Experiencing Adverse Events (AEs), Number of Participants Discontinuing Study Drug Due to AEs
Endpoint(s): ORR by IWG Response Criteria (Cheson, 2007) per Site Assessment (rrcHL Cohort), DOR per RECIST 1.1 by Site Assessment (Advanced Melanoma, Solid Tumors and Other Lymphoma, Each Disease Indication Is Evaluated Separately), DOR per RECIST 1.1 by Site or BIRC Assessment (MSI-H and TMBH, Each Cohort Is Evaluated Separately), DOR per IWG 2007 (Cheson, 2007) Response by BICR Assessment (rrcHL Cohort), DOR per IWG 2007 (Cheson, 2007) Response by Site Assessment (rrcHL Cohort), DOR per Immune-related Response Evaluation Criteria in Solid Tumors (irRECIST) by Site Assessment (Solid Tumors and Other Lymphoma, Each Disease Indication Evaluated Separately), DOR per irRECIST by Site Assessment (MSI-H and TMB-H, Each Cohort Is Evaluated Separately), Progression-free Survival (PFS) Using RECIST 1.1 Criteria by Site Assessment (Solid Tumors and Other Lymphoma, Each Disease Indication Evaluated Separately), PFS using RECIST 1.1 Criteria by Site or BIRC Assessment (MSI-H and TMB-H, Each Cohort Evaluated Separately), PFS using IWG 2007 Criteria (Chesson 2007) by BICR Assessment (rrcHL Cohort), PFS using IWG 2007 Criteria (Chesson, 2007) by Site Assessment (rrcHL Cohort), PFS Using irRECIST Criteria by Site Assessment, Disease Control Rate by RECIST 1.1 Using Site Assessment (Solid Tumors and Other Lymphoma, Each Disease Indication Evaluated Separately), Disease Control Rate by RECIST 1.1 Using Site or BIRC Assessment (MSI-H and TMB-H, Each Cohort Evaluated Separately), Disease Control Rate by irRECIST Using Site Assessment (Solid Tumors and Other Lymphomas, Each Disease Indication Evaluated Separately), Overall Survival, Objective irRECIST Response Rate by Site Assessment (Each Disease Indication Evaluated Separately), Area Under the Concentration Curve (AUC) for Pembrolizumab

Source: https://euclinicaltrials.eu/ctis-public/view/2022-501257-36-00